EU clinical trial 2023-509510-11-00: QIMPD SUBMISSION ONLY - MorningLyte - A Phase III randomized, open-label, international, multicenter study evaluating the efficacy and safety of mosunetuzumab plus lenalidomide in comparison to anti-CD20 monoclonal antibody plus chemotherapy in subjects with previously untreated FLIPI 2-5 follicular lymphoma (title noted in the current version of the protocol)
Protocol code: MO44842
Sponsor: F. Hoffmann-La Roche AG (Pharmaceutical company). Phase: Therapeutic confirmatory (Phase III). Countries: Belgium (not authorised).
Therapeutic area(s): Diseases [C] - Neoplasms [C04]
Gender: Female, Male. Age: 18-64 years, 65+ years. Enrolment: 1.
Status: Not authorised. Decision date: 2024-04-29. Results received: No. Last updated: 2024-04-29.

Product: Mosunetuzumab, Mosunetuzumab

Source: https://euclinicaltrials.eu/ctis-public/view/2023-509510-11-00